EU clinical trial 2025-522160-32-00: A single arm, open label, multicenter, single-dose, phase 2b clinical study evaluating efficacy and safety of gene therapy using autologous CD34+ hematopoietic stem cells transduced with the GLOBE lentiviral vector using an improved transduction protocol in subjects with transfusion-dependent beta-thalassemia.
Sponsor: Fondazione Telethon Ets, San Raffaele Hospital (Patient organisation/association, Hospital/Clinic/Other health care facility). Phase: Therapeutic exploratory (Phase II). Countries: Italy (ongoing, recruiting).
Therapeutic area(s): Diseases [C] - Hemic and Lymphatic Diseases [C15]; Diseases [C] - Congenital, Hereditary, and Neonatal Diseases and Abnormalities [C16]
Gender: Female, Male. Age: 0-17 years, 18-64 years. Enrolment: 9.
Status: Ongoing, recruiting. Start date (EU): 2026-07-03. Decision date: 2025-12-18. Results received: No. Last updated: 2026-05-20.

Condition(s): transfusion-dependent beta-thalassemia
Product: Busulfan Koanaa 6 mg/ml Konzentrat zur Herstellung einer Infusionslösung, GRANOCYTE 34 Millions UI/ml, poudre et solvant pour solution injectable / perfusion, Autologous CD34+ cells transduced with lentiviral vector encoding the human beta-globin gene, Plerixafor Accord 20 mg/ml solution for injection

Primary endpoint: Proportion of Subjects achieving transfusion independence defined as a weighted average Hb ≥ 9.0 gr/dL without any red blood cell transfusion for a continuous period of ≥ 12 months (TI12) at any time during the study after the drug product administration. The assessment of TI12 starts 60 days after last RBC transfusion for post-transplant support or BTHAL standard of care.
Endpoint(s): Overall survival at 12 and 24 months post GT., Evaluation of the safety of treatment, Evaluation of biological correlates of safety

Source: https://euclinicaltrials.eu/ctis-public/view/2025-522160-32-00